EU clinical trial 2024-512470-10-00: Maintaining or Stopping immunosuppressive Therapy in patients with ANCA vasculitis and End-stage Renal disease: a prospective, multicenter, randomized, open-label, clinical trial
Protocol code: CHD005-17
Sponsor: Centre Hospitalier Departemental Vendee (Hospital/Clinic/Other health care facility). Phase: Phase III and phase IV (Integrated). Countries: France (ongoing, recruitment ended).
Therapeutic area(s): Analytical, Diagnostic and Therapeutic Techniques and Equipment [E] - Therapeutics [E02]
Gender: Female, Male. Age: 18-64 years, 65+ years. Enrolment: 136.
Status: Ongoing, recruitment ended. Start date (EU): 2018-02-02. Decision date: 2024-04-09. Results received: No. Last updated: 2026-02-12.

Condition(s): End-stage Renal disease, ANCA vasculitis
Product: RITUXIMAB, PREDNISONE, CORTANCYL 20 mg, comprimé sécable, AZATHIOPRINE, MYCOPHENOLIC ACID, Imurel 25 mg tabletter, Mycophenolate mofetil Tillomed 500 mg film-coated tablets

Primary endpoint: The primary end point will be the time between randomization and the first severe prejudicial event (severe infection, major AAV relapse, death) during 24 months of follow-up.

Source: https://euclinicaltrials.eu/ctis-public/view/2024-512470-10-00